EU clinical trial 2024-511490-29-00: A randomized, double-blind, placebo-controlled, phase III study evaluating the efficacy and safety of pembrolizumab plus platinum-based doublet chemotherapy with or without canakinumab as first line therapy for locally advanced or metastatic non-squamous and squamous non-small cell lung cancer subjects (CANOPY-1)
Protocol code: CACZ885U2301
Sponsor: Novartis Pharma AG (Pharmaceutical company). Phase: Therapeutic confirmatory (Phase III). Countries: Spain (ended), Germany (ended).
Therapeutic area(s): Diseases [C] - Neoplasms [C04]
Gender: Female, Male. Age: 18-64 years, 65+ years. Enrolment: 3.
Status: Ended. Start date (EU): 2019-01-24. End date (EU): 2025-11-25. End date: 2026-01-26. Decision date: 2024-06-07. Results received: No. Last updated: 2025-09-05.
Decision dates by country: DE: 2024-06-11, ES: 2024-06-07

Condition(s): Non-small cell lung cancer
Product: CANAKINUMAB, PEMETREXED

Primary endpoint: Safety run-in part: Incidence of dose limiting toxicities in the first 42 days of study treatment., Double-blind, randomized, placebo-controlled part: PFS based on local investigator assessment as per RECIST 1.1, Double-blind, randomized, placebo-controlled part: OS
Endpoint(s): Safety run-in part: 1. Concentration and PK parameters of canakinumab, pembrolizumab and chemotherapy, Safety run-in part: 2. Type, frequency and severity of adverse events and reactions, changes in laboratory values, vital signs, ECGs, Safety run-in part: 3. ORR, DCR, DOR by investigator's assessment according to RECIST 1.1, Safety run-in part: 4. Anti-drug antibodies (ADA) prevalence at baseline and ADA incidence on-treatment of canakinumab and pembrolizumab, Double-blind, randomized, placebo-controlled part: 1. ORR, DCR, TTR and DOR based on local investigator assessment as per RECIST 1.1, Double-blind, randomized, placebo-controlled part: 2. Frequency of adverse events, serious adverse events, AEs leading to treatment discontinuation, proportion of patients with laboratory abnormalities, ECG, and vital signs., Double-blind, randomized, placebo-controlled part: 3. Concentration and PK parameters of canakinumab, pembrolizumab and chemotherapy, Double-blind, randomized, placebo-controlled part: 4. Anti-drug antibodies (ADA) prevalence at baseline and ADA incidence on-treatment of canakinumab and pembrolizumab, Double-blind, randomized, placebo-controlled part: 5. Time to definitive 10-point deterioration symptom scores for chest pain, cough and dyspnea per QLQ-LC13 questionnaire as three primary PRO variables of interest and time to definitive deterioration in global health status/QoL, shortness of breath and pain per QLQ-C30 as secondary PRO variables of interest.

Source: https://euclinicaltrials.eu/ctis-public/view/2024-511490-29-00